EU clinical trial 2024-520385-57-01: A study to find how well budoprutug (TNT119) works and how safe it is in participants with Systemic Lupus Erythematosus
Protocol code: TNT119-SLE-101
Sponsor: Climb Bio Inc. (Pharmaceutical company). Phase: Human Pharmacology (Phase I)- Other. Countries: Romania (ongoing, recruiting), Bulgaria (ongoing, recruiting), Greece (authorised, recruiting), Spain (ongoing, recruiting).
Therapeutic area(s): Diseases [C] - Immune System Diseases [C20]
Gender: Female, Male. Age: 18-64 years, 65+ years. Enrolment: 11.
Start date (EU): 2025-11-26. Decision date: 2025-10-31. Results received: No. Last updated: 2026-06-30.
Decision dates by country: ES: 2025-10-31, RO: 2025-11-03, BG: 2025-11-03, GR: 2025-10-31

Condition(s): Systemic Lupus Erythematosus

Source: https://euclinicaltrials.eu/ctis-public/view/2024-520385-57-01